EU clinical trial 2024-518337-29-00: Pulmonary pharmacokinetics of piperacillin/tazobactam and levofloxacin in patients with chronic obstructive pulmonary disease or cystic fibrosis: Comparison of epithelial lining fluid, in-vivo microdialysis and tissue biopsy. An exploratory pharmacokinetic study.
Sponsor: Medical University Of Vienna (Educational Institution). Phase: Therapeutic use (Phase IV). Countries: Austria (ongoing, recruiting).
Therapeutic area(s): Diseases [C] - Respiratory Tract Diseases [C08]
Gender: Female, Male. Age: 18-64 years, 65+ years. Enrolment: 18.
Status: Ongoing, recruiting. Start date (EU): 2024-12-11. Decision date: 2024-12-11. Results received: No. Last updated: 2024-12-11.

Condition(s): chronic obstructive pulmonary disease, cystic fibrosis
Product: Levofloxacin Kabi 5 mg/ml Infusionslösung, Piperacillin/Tazobactam Kabi 4 g/0,5 g Pulver zur Herstellung einer Infusionslösung

Primary endpoint: Antibiotic concentrations in ELF and tissue biopsy at 75' and in-vivo microdialysis concentrations during the 60-90' interval.

Source: https://euclinicaltrials.eu/ctis-public/view/2024-518337-29-00